EU clinical trial 2023-507409-32-00: A study to investigate the safety, pharmacodynamics and pharmacokinetics of increasing doses of subcutaneously administered deuterated DMT (CYB004) in healthy subjects
Sponsor: Cybin IRL Limited (Pharmaceutical company). Phase: Human Pharmacology (Phase I)- Other. Countries: Netherlands (ended).
Therapeutic area(s): Psychiatry and Psychology [F] - Mental Disorders [F03]
Gender: Female. Age: 18-64 years. Enrolment: 72.
Status: Ended. End date (EU): 2024-06-26. Decision date: 2023-12-14. Results received: No. Last updated: 2023-12-14.

Condition(s): Depression and anxiety disorders

Source: https://euclinicaltrials.eu/ctis-public/view/2023-507409-32-00